EU clinical trial 2024-517302-29-00: Impact of Analgesia on Success of External Version: Comparison of Spinal Anesthesia Versus Sedation; Prospective, Controlled, Randomized Study
Sponsor: Centre Hospitalier Universitaire Amiens Picardie (Hospital/Clinic/Other health care facility). Phase: Therapeutic confirmatory (Phase III). Countries: France (authorised, recruiting).
Therapeutic area(s): Diseases [C] - Female Urogenital Diseases and Pregnancy Complications [C13]
Gender: Female. Age: 18-64 years. Enrolment: 200.
Status: Authorised, recruiting. Start date (EU): 2024-09-30. Decision date: 2024-09-30. Results received: No. Last updated: 2024-09-30.

Condition(s): anaesthesia: comparison of spinal anaesthesia with sedation
Product: Midazolam 1 mg/ml Solution for Injection or Infusion, BUPIVACAINE VIATRIS 20 mg/4 ml, solution injectable pour voie intra rachidienne en ampoule

Primary endpoint: Successful EMV once the procedure has been completed, i.e. a foetus in cephalic presentation.
Endpoint(s): Events secondary to the procedure: caesarean section for permanent bradycardia, retroplacental haematoma, rupture of membranes, Events secondary to the anaesthetic: hypotension, bradycardia, desaturation, nausea/vomiting, number of punctures greater than 11 (failure of the first spinal puncture and need for one or more others), The pain felt by the patient: assessed by VAS, Final route of delivery, Presentation at delivery

Source: https://euclinicaltrials.eu/ctis-public/view/2024-517302-29-00